EU clinical trial 2023-503614-80-00: A Phase 3, Randomized, Double-Blind, Placebo-Controlled Study to Evaluate the Efficacy and Safety of Oral Inhalation of Seralutinib for the Treatment of Pulmonary Arterial Hypertension (PAH)
Protocol code: GB002-3101
Sponsor: GB002 Inc. (Pharmaceutical company). Phase: Therapeutic confirmatory (Phase III). Countries: Spain (ended), Lithuania (ended), Greece (ended), France (ended), Denmark (ended), Germany (ended), Belgium (ended), Portugal (ended), Czechia (ended), Latvia (ended), Netherlands (ended), Poland (ended), Italy (ended), Romania (ended), Austria (ended), Ireland (ended).
Therapeutic area(s): Diseases [C] - Cardiovascular Diseases [C14]
Gender: Female, Male. Age: 18-64 years, 65+ years. Enrolment: 169.
Status: Ended. Start date (EU): 2023-12-14. End date (EU): 2025-12-22. End date: 2025-12-23. Decision date: 2023-11-23. Results received: No. Last updated: 2025-11-07.
Decision dates by country: AT: 2023-11-23, LT: 2023-11-27, IT: 2023-11-27, NL: 2023-11-27, CZ: 2023-11-24, IE: 2024-03-15, RO: 2023-11-30, LV: 2023-11-24, DK: 2023-11-23, GR: 2023-11-28, PT: 2023-11-27, ES: 2023-11-23, PL: 2023-11-24, BE: 2023-11-24, DE: 2023-11-24, FR: 2023-11-28

Condition(s): Pulmonary Arterial Hypertension
Product: GB002, The placebo is an inhalation powder, comprised in a capsule identical in size, shape, and color to the drug product and contains lactose monohydrate. The placebo is administered the same way as the drug product via an inhaler device.

Primary endpoint: Change in distance achieved on the six-minute walk test (6MWT) from baseline to Week 24
Endpoint(s): 1.- 3. Time to first event of Clinical Worsening from first dose of Investigational Product (IP) through end of study 2. Proportion of subjects who achieve all of the components of a composite endpoint of clinical improvement at Week 24, in the absence of clinical worsening 3. Change in NT-proBNP from baseline to Week 24, 4.-5. 4. Proportion of subjects with ≥ 1 point decrease from baseline in REVEAL Lite 2 Risk Score at Week 24 5. Incidence of treatment-emergent adverse events (TEAEs), serious TEAEs (SAEs), and treatment-emergent adverse events of special interest (AESIs)

Source: https://euclinicaltrials.eu/ctis-public/view/2023-503614-80-00